EU clinical trial 2024-515292-35-00: Wilms’ tumor (WT1) antigen-targeted dendritic cell vaccination to prevent relapse in adult patients with acute myeloid leukemia: a multicenter randomized phase II trial
Protocol code: WIDEA
Sponsor: Antwerp University Hospital (Hospital/Clinic/Other health care facility). Phase: Therapeutic exploratory (Phase II). Countries: Belgium (ongoing, recruitment ended).
Therapeutic area(s): Diseases [C] - Neoplasms [C04]; Analytical, Diagnostic and Therapeutic Techniques and Equipment [E] - Therapeutics [E02]; Diseases [C] - Hemic and Lymphatic Diseases [C15]; Phenomena and Processes [G] - Immune system processes [G12]
Gender: Female, Male. Age: 18-64 years, 65+ years. Enrolment: 130.
Status: Ongoing, recruitment ended. Start date (EU): 2026-01-09. Decision date: 2024-10-31. Results received: No. Last updated: 2026-01-22.

Condition(s): Acute Myeloid Leukemia
Product: WT1 mRNA DC

Primary endpoint: Primary end point: Overall survival
Endpoint(s): Secondary end point 1 and 2: Clinical response analysis will be performed on all efficacy-evaluable patients according to the ‘Revised Recommendations of the International Working Group for Diagnosis, Standardization of Response Criteria, Treatment Outcomes, and Reporting Standards for Therapeutic Trials in Acute Myeloid Leukemia’. Secondary endpoints that will be analyzed are relapse-free survival and relapse rate at two years, Secondary end point 3: Both for the control group and the intervention group, tumor marker levels will be monitored in peripheral blood. This will be done by measuring WT1 mRNA levels using specific primers and quantitative real-time RT-PCR. Molecular response is defined as the normalization of WT1 transcript levels in peripheral blood below background, Secondary end point 4: Both for the control group and the intervention group, activation of the immune system will be monitored. Peripheral blood samples will be examined by using flow cytometry for functional WT1-specific T cell responses (e.g. WT1-reactive IFN-γ+ T cells), WT1-specific CD8+ T cells (by tetramer analysis in HLA-A*0201+ patients) and changes in lymphocyte subset distribution and activation state, Secondary end point 5: Patient-reported outcomes, to evaluate changes in general and disease-specific quality of life using EQ-5D-5L and QLQ-C30 questionnaires at regular time points

Source: https://euclinicaltrials.eu/ctis-public/view/2024-515292-35-00